EU clinical trial 2024-518556-22-00: A Randomized, Double-Blind, Placebo-Controlled, Parallel Group, Multi-center, Phase III Study to Evaluate the Efficacy and Safety of Baricitinib as a Remission-Induction and Glucocorticoid-Sparing Regimen in Subjects with New-Onset Polymyalgia Rheumatica (JAK-SPARE 1)
Protocol code: JAK-SPARE 1
Sponsor: Medical University Of Vienna (Educational Institution). Phase: Therapeutic confirmatory (Phase III). Countries: Austria (ended), Czechia (ended), Italy (ended).
Therapeutic area(s): Diseases [C] - Musculoskeletal Diseases [C05]
Gender: Female, Male. Age: 18-64 years, 65+ years. Enrolment: 46.
Status: Ended. Start date (EU): 2022-05-10. End date (EU): 2026-04-13. Decision date: 2024-12-09. Results received: No. Last updated: 2024-12-11.
Decision dates by country: AT: 2024-12-09, CZ: 2024-12-10, IT: 2024-12-11

Condition(s): polymyalgia rheumatica
Product: Olumiant 2 mg film-coated tablets, Olumiant 4 mg film-coated tablets, placebo to match baricitinib 4mg and 2mg in appearance

Primary endpoint: Proportion of subjects in GC free remission at week 16 (Part I)
Endpoint(s): Proportion of subjects in GC free remission at week 12 (Part I), 28 (Part II) and 44 (Part III), Cumulative GC doses at weeks 12, 16 (Part I), 28 (Part II) and 44 (Part III), Number of relapses per patient at weeks 12, 16 (Part I), 28 (Part II) and 44 (Part III), Time to first and second relapse, Glucocorticoid dose intensity (absolute and relative) at week 16, Patient reported outcomes including SF-36, FACIT-Fatigue, HAQ, Patient Global Assessment of Disease Activity (PGA), Patient assessment of pain, Investigator reported outcomes including Evaluator Global Assessment of disease activity (EGA), duration and severity of Morning Stiffness, semiquantitative elevation of upper limbs’ scale, Laboratory markers of inflammation including ESR and CRP, Polymyalgia Rheumatica Activity Score (PMR-AS), Occurrence of adverse events and serious adverse events, incidence of GC-related adverse events, changes in vital signs, haematology and clinical chemistry parameter

Source: https://euclinicaltrials.eu/ctis-public/view/2024-518556-22-00